EU clinical trial 2025-520471-29-00: Efficacy of the use of neoadjuvant with/without hyperthermic intraperitoneal chemotherapy in the treatment of locally advanced colon cancer: A phase III multi-arm, randomized and controlled clinical trial (FOXHIPECT4)
Protocol code: FCO-FOX-2024-01
Sponsor: Fundacion Para La Investigacion Biomedica De Cordoba (Laboratory/Research/Testing facility). Phase: Therapeutic confirmatory (Phase III). Countries: Spain (ongoing, recruiting).
Therapeutic area(s): Diseases [C] - Digestive System Diseases [C06]; Diseases [C] - Neoplasms [C04]
Gender: Female, Male. Age: 18-64 years, 65+ years. Enrolment: 1083.
Status: Ongoing, recruiting. Start date (EU): 2026-05-26. Decision date: 2025-08-05. Results received: No. Last updated: 2026-06-29.

Condition(s): Locally advanced adenocarcinoma of the colon and upper rectum with microsatellite stability and with stage cT4N0-2M0 (possible cT3 with pericolic fat penetration > 5mm) by imaging test (CT scan or MRI).
Product: OXALIPLATIN, FLUOROURACIL, MITOMYCIN, CAPECITABINE, FOLINIC ACID

Primary endpoint: disease-free survival (DFS; absolute DFS in months), Probability of DFS at 3 years (DFS 3y%)
Endpoint(s): Overall survival: absolute and probability at 3 years, Peritoneal recurrence-free survival: absolute and probability at 3 years, Pattern of recurrence (peritoneal, hematogenous or lymphatic), Tumor regression grade (Dworak scale), Morbidity and toxicity: Clavien Dindo classification and Common Terminology Criteria for Adverse Events (CTCAE) v5.0 will be considered., Negative rate of ctDNA after treatment and association of detected levels with tumor recurrence and survival, Survival analysis in the following subgroups: pT4a/b, pN+, pathologic stage II/III, mutated RAS/RAF, positive/negative ctDNA, Tumour progression defined as per RECIST v.1.1: at least a 20% increase in the sum of diameters of target lesions, taking as reference the smallest sum on study (this includes the baseline sum if that is the smallest on study). In addition to the relative increase of 20%, the sum must also demonstrate an absolute increase of at least 5 mm. (Note: the appearance of one or more new lesions is also considered progression).

Source: https://euclinicaltrials.eu/ctis-public/view/2025-520471-29-00